EU clinical trial 2023-509449-10-00: A Phase II, Randomized, Double-Blind Study of Atezolizumab Plus Tiragolumab and Atezolizumab Plus Placebo as First-Line Treatment in Patients with Recurrent/Metastatic PD-L1-Positive Squamous Cell Carcinoma of the Head and Neck
Protocol code: BO42533
Sponsor: F. Hoffmann-La Roche AG (Pharmaceutical company). Phase: Therapeutic exploratory (Phase II). Countries: Greece (ended), France (ended), Poland (ended), Czechia (ended), Spain (ended), Hungary (ended).
Therapeutic area(s): Diseases [C] - Neoplasms [C04]
Gender: Female, Male. Age: 18-64 years, 65+ years. Enrolment: 72.
Status: Ended. Start date (EU): 2021-03-16. End date (EU): 2025-08-27. End date: 2025-08-28. Decision date: 2024-07-31. Results received: Yes. Last updated: 2025-08-04.
Decision dates by country: CZ: 2024-08-01, GR: 2024-08-01, HU: 2024-07-31, ES: 2024-07-31, PL: 2024-08-06, FR: 2024-07-31

Condition(s): Squamous cell carcinoma of the head and neck (SCCHN)
Product: Tiragolumab placebo, Tiragolumab, Tecentriq 1 200 mg concentrate for solution for infusion

Primary endpoint: 1. Confirmed objective response rate
Endpoint(s): 1. Duration of Response, 2. Progression free survival, 3. Overall survival, 4. Progression free survival rate at 6 months, 5. Overall survival rate at 6 months and 12 months, 6.Time to confirmed deterioration in patient-reported physical functioning, 7. Incidence and severity of adverse events, with severity determined according to National Cancer Institute Common Terminology Criteria for Adverse Events, Version 5.0, 8. Serum concentration of atezolizumab and tiragolumab at specified timepoints, 9. Prevalence of anti-drug antibodies (ADAs) to atezolizumab at baseline and during the study, 10.Prevalence of ADAs to tiragolumab at baseline and during the study

Source: https://euclinicaltrials.eu/ctis-public/view/2023-509449-10-00